EU clinical trial 2024-514733-38-00: Randomized, double-blind, phase 3 study of tucatinib or placebo in combination with ado-trastuzumab emtansine (T-DM1) for subjects with unresectable locally-advanced or metastatic HER2+ breast cancer (HER2CLIMB-02)
Protocol code: SGNTUC-016
Sponsor: Seagen Inc. (Pharmaceutical company). Phase: Therapeutic confirmatory (Phase III). Countries: France (ongoing, recruitment ended), Netherlands (ended), Germany (ended), Denmark (ended), Spain (ended), Sweden (ended), Italy (ended), Belgium (ended).
Therapeutic area(s): Diseases [C] - Neoplasms [C04]
Gender: Female, Male. Age: 18-64 years, 65+ years. Enrolment: 101.
Start date (EU): 2020-11-03. Decision date: 2024-07-18. Results received: No. Last updated: 2025-10-20.
Decision dates by country: SE: 2024-07-22, BE: 2024-07-22, ES: 2024-07-18, DK: 2024-07-21, DE: 2024-07-22, IT: 2024-08-05, NL: 2024-08-05, FR: 2024-08-13

Condition(s): Unresectable locally-advanced or metastatic HER2+ breast cancer
Product: Tucatinib 50mg placebo tablets, TUKYSA 50 mg film-coated tablets, Kadcyla 160 mg powder for concentrate for solution for infusion., Tucatinib 150mg placebo tablets, TUKYSA 150 mg film-coated tablets

Primary endpoint: PFS per RECIST v1.1, as determined by investigator assessment
Endpoint(s): OS, PFS.BM per RECIST v1.1, as determined by investigator assessment, ORR per RECIST v1.1, by investigator assessment, OS.BM

Source: https://euclinicaltrials.eu/ctis-public/view/2024-514733-38-00